EU clinical trial 2024-516461-36-00: CHASAP : Chronic Hypertension and Acetyl Salicylic Acid in Pregnancy, a multicenter prospective randomized double-blind placebo-controlled trial.
Protocol code: CHASAP
Sponsor: Centre Hospitalier Intercommunal Creteil (Hospital/Clinic/Other health care facility). Phase: Therapeutic confirmatory (Phase III). Countries: France (ongoing, recruiting).
Therapeutic area(s): Diseases [C] - Female Urogenital Diseases and Pregnancy Complications [C13]
Gender: Female. Age: 18-64 years. Enrolment: 500.
Status: Ongoing, recruiting. Start date (EU): 2021-01-27. Decision date: 2024-10-17. Results received: No. Last updated: 2026-02-10.

Condition(s): Pregnancy associated hypertension, Pre-Eclampsia, Fetal growth restriction
Product: ACARD 150 mg, 150 mg, tabletki dojelitowe, Acetylsalicylic acid PLACEBO

Primary endpoint: It is a composite morbidity-mortality criterion comprising at least one of the following: - Preeclampsia (early or late) - Birthweight <10 percentile - Placental abruption - Perinatal death - Maternal death - Preterm delivery < 37 weeks of gestation
Endpoint(s): Rate of the composite morbidity-mortality criterion in 2 subgroups: treatment started before or after 15 SA, Each of the events of primary end-point taken individually,, Rate of severe PE, Rate of severe IUGR (< 5th percentile of birth weight),, Rate of severe preterm delivery (< 34 weeks of gestation),, Rate of fetal loss (fetal loss between 10 and 21 weeks of gestation),, Rate of fetal death (fetal death from 22 weeks of gestation until delivery),, Rate of neonatal death (death from birth until 28 days),, Neonatal morbidity • stay in a neonatal intensive care unit, • assisted ventilation > 24 hours, • hyaline membrane disease, • intraventricular hemorrhages stage III or IV,, Potential toxicity of the treatment: major maternal bleeding event (active externalized, intracranial, intra-ocular, retroperitoneal, articular), or minor, Adherence of treatment (diary) and its relationship with the efficacy of the preventive effect on primary outcome,, Biological response to the treatment (response to the treatment will be defined as a serum thromboxane B2 > 10ng/mL), Circulating and urinary angiogenic profile associated with maternal and fetal clinical data: sFLT1 (serum and urine), PlGF (serum and urine), Child psychomotor development and health problems at 2 and 4 years of age

Source: https://euclinicaltrials.eu/ctis-public/view/2024-516461-36-00